EU clinical trial 2023-505041-52-00: A trial to learn if different doses of REGN17092 are safe in healthy adults
Protocol code: R17092-HV-2312
Sponsor: Regeneron Pharmaceuticals Inc. (Pharmaceutical company). Phase: Human Pharmacology (Phase I)- First administration to humans. Countries: Belgium (ended).
Therapeutic area(s): Diseases [C] - Virus Diseases [C02]
Gender: Female, Male. Age: 18-64 years. Enrolment: 128.
Status: Ended. Start date (EU): 2023-11-28. End date (EU): 2025-03-04. End date: 2025-03-05. Decision date: 2023-08-16. Results received: No. Last updated: 2024-11-13.

Condition(s): SARS-CoV-2 (COVID-19)

Source: https://euclinicaltrials.eu/ctis-public/view/2023-505041-52-00